EU clinical trial 2024-512317-40-00: Phase 1/2 Study to Evaluate Safety, Tolerability, Pharmacokinetics, and Pharmacodynamics of NTLA-2002 in Adults with Hereditary Angioedema (HAE)
Sponsor: Intellia Therapeutics Inc. (Pharmaceutical company). Phase: Phase I and Phase II (Integrated)- Other. Countries: Germany (ended), France (ended), Netherlands (ended).
Therapeutic area(s): Diseases [C] - Congenital, Hereditary, and Neonatal Diseases and Abnormalities [C16]
Gender: Female, Male. Age: 18-64 years, 65+ years. Enrolment: 15.
Status: Ended. Start date (EU): 2022-04-13. End date (EU): 2026-06-26. Decision date: 2024-05-13. Results received: No. Last updated: 2026-03-04.
Decision dates by country: FR: 2024-05-14, DE: 2024-05-15, NL: 2024-05-13

Condition(s): Hereditary Angioedema
Product: NTLA-2002, Normal saline (0.9% Sodium Chloride Injection, USP [or local pharmacopeia equivalent]) will be used for placebo

Primary endpoint: Phase 1: Primary Endpoint: - Safety and tolerability as determined by adverse events (AEs) - Dose-limiting toxicities (DLTs) Phase 2: - Number of HAE attacks per month (by HAE Attack Assessment and Reporting Procedure – see Section 10.3), Weeks 1 to 16 - Placebo Crossover and Follow-on Dosing Substudy: Safety as determined by AEs
Endpoint(s): Phase 1: - Change from baseline in total plasma prekallikrein/kallikrein protein level, Phase 1: • Plasma and urine concentrations for DMG-PEG2k, LP000001, clustered regularly interspaced short palindromic repeats (CRISPR)/CRISPR-associated protein 9 (Cas9) messenger ribonucleic acid (mRNA), and single guide RNA (sgRNA), Phase 2: Safety and tolerability as determined by AEs, Phase 2: Number of HAE attacks per month (by HAE Attack Assessment and Reporting Procedure – see Section 10.3) (Weeks 5 to 16) and number of HAE attacks requiring acute therapy per month (Weeks 1 to 16, Weeks 5 to 16), Phase 2: Number of moderate or severe HAE attacks per month (Weeks 5 to 16), Phase 2: Change from baseline in total plasma prekallikrein/kallikrein protein level, Phase 2: Plasma and urine concentrations for DMG-PEG2k, LP000001, Cas9 mRNA, and sgRNA, Placebo Crossover and Follow-on Dosing Substudy: • Number of HAE attacks per month (Weeks 1 to 16 and Weeks 5 to 16 following crossover or follow-on dose) • Number of HAE attacks requiring acute therapy per month (Weeks 1 to 16 and Weeks 5 to 16 following crossover or follow-on dose) • Number of moderate or severe HAE attacks per month (Weeks 1 to 16 and Weeks 5 to 16 following crossover or follow-on dose) • Plasma and urine concentrations for DMG-PEG2k, LP000001, Cas9 mRNA, and sgRNA

Source: https://euclinicaltrials.eu/ctis-public/view/2024-512317-40-00